EU clinical trial 2023-503462-23-00: A randomized, double-blind, placebo-controlled, parallel group, Phase 3 study, followed by open-label extensions, to evaluate the efficacy of oral belumosudil in adult participants with chronic lung allograft dysfunction (CLAD) following bilateral lung transplantation
Protocol code: EFC17801
Sponsor: Sanofi-Aventis Recherche & Developpement (Pharmaceutical company). Phase: Therapeutic confirmatory (Phase III). Countries: Denmark (ongoing, recruiting), Italy (ongoing, recruiting), Spain (ongoing, recruiting), Austria (ongoing, recruiting), Netherlands (ongoing, recruiting), Hungary (ongoing, recruiting), France (ongoing, recruiting), Germany (ongoing, recruiting), Czechia (ongoing, recruiting), Norway (ended), Finland (ongoing, recruiting), Belgium (ongoing, recruiting), Poland (ended), Sweden (authorised, recruitment pending).
Therapeutic area(s): Diseases [C] - Immune System Diseases [C20]
Gender: Female, Male. Age: 18-64 years, 65+ years. Enrolment: 77.
Start date (EU): 2023-12-28. Decision date: 2023-10-09. Results received: No. Last updated: 2026-08-03.
Decision dates by country: DK: 2023-10-09, PL: 2023-10-16, SE: 2025-08-13, AT: 2023-10-16, BE: 2023-10-13, CZ: 2023-10-12, DE: 2023-10-12, FI: 2023-10-10, HU: 2023-10-11, IT: 2023-10-10, NL: 2023-10-09, NO: 2023-10-13, ES: 2023-10-16, FR: 2023-10-10

Condition(s): Lung transplant rejection
Product: AZITHROMYCIN, same excipients except no hypromellose, SAR445761 - belumosudil

Primary endpoint: Percent change from baseline to Week 26 in FEV1
Endpoint(s): Response rate at Week 26. Defined as the proportion of participants with ≤10% decline in FEV1 at Week 26 compared with baseline, Absolute change from baseline to Week 26 in FEV1, Absolute change from baseline to Week 26 in percent predicted FEV1, Percent change from baseline to Week 26 in FVC, Absolute change from baseline to Week 26 in FVC, Absolute change from baseline to Week 26 in percent predicted FVC, Time to CLAD progression during the doubleblind treatment period.Defined as the first of the following events: >10% decline in FEV1 compared with baseline, or change in CLAD stage, or re-transplantation, or death., Time to re-transplantation or death, Percent change from baseline to Week 26 in 6- minute walk distance, Absolute change from baseline to Week 26 in 6-minute walk distance, Change from baseline to Week 26 in Saint George Respiratory Questionnaire (SGRQ). Total score and scores by domain, Change from baseline to Week 26 in EQ-5D-5L.Visual analogue scale and individual dimensions, Change from baseline to Week 26 in Patient- Reported Outcomes Measurement Information System-29 profile version 2.1. PROMIS-29 profile V2.1 (domain scores), Number of participants with adverse events (AEs) and serious adverse events (SAEs). Treatment-emergent adverse events (TEAEs), serious adverse events (SAEs), adverse events of special interest (AESIs), as well as laboratory abnormalities during the double-blind treatment period and the open-label extensions

Source: https://euclinicaltrials.eu/ctis-public/view/2023-503462-23-00